EU clinical trial 2024-513697-22-00: A randomized, open-label, controlled phase III trial comparing the pembrolizumab platinum based chemotherapy combination with pembrolizumab monotherapy in first line treatment of non small-cell lung cancer (NSCLC) patients with PD L1 expression ≥50% on tumor cells : PERSEE TRIAL
Sponsor: Centre Hospitalier Regional Et Universitaire De Brest (Hospital/Clinic/Other health care facility). Phase: Therapeutic confirmatory (Phase III). Countries: France (ended).
Therapeutic area(s): Diseases [C] - Respiratory Tract Diseases [C08]
Gender: Female, Male. Age: 18-64 years, 65+ years. Enrolment: 349.
Status: Ended. Start date (EU): 2024-11-07. End date (EU): 2025-12-22. Decision date: 2024-11-07. Results received: No. Last updated: 2024-11-07.

Condition(s): non-small-cell lung cancer

Source: https://euclinicaltrials.eu/ctis-public/view/2024-513697-22-00